EU clinical trial 2024-514329-42-00: Metronomic neoadjuvant capecitabine and cyclophosphamide in huge (PCI>28) Pseudomyxoma peritonei (PMP) patients candidates to cytoreductive surgery (CRS) and hypertermic intraperitoneal chemotherapy (HIPEC).
Protocol code: REVERSE
Sponsor: Fondazione IRCCS Istituto Nazionale Dei Tumori (Hospital/Clinic/Other health care facility). Phase: Therapeutic exploratory (Phase II). Countries: Italy (ongoing, recruiting).
Therapeutic area(s): Diseases [C] - Neoplasms [C04]
Gender: Female, Male. Age: 18-64 years, 65+ years. Enrolment: 31.
Status: Ongoing, recruiting. Start date (EU): 2024-11-22. Decision date: 2024-09-23. Results received: No. Last updated: 2025-12-03.

Condition(s): Pseudomyxoma peritonei patients with high tumor burden.
Product: Capecitabina Zentiva 500 mg compresse rivestite con film., Endoxan Baxter 50 mg Compresse rivestite, CAPECITABINE

Primary endpoint: We will use Completeness of Cytoreduction to evaluate the radicality of CRS: patients with a residual disease <2.5 mm will be considered completely cytoreduced, otherwise incompletely cytoreduced,
Endpoint(s): Objective tumor response rate will be defined by two independent radiologists by means of CT (computed tomography) scans performed at baseline, and after 16 weeks., Conversion rate will be calculated dividing the number of resectable cases after the neoadjuvant chemotherapy by the number of resectable cases before neoadjuvant chemotherapy. Resectability will be evaluated with CT scans using Bouquot et al. methodology., Downsizing of the tumor will be measured at the time of staging laparoscopy and CRS using Peritoneal Cancer Index (PCI)., Safety and tolerability objective will be measured by the incidence of adverse events (AEs), serious adverse events (SAEs), deaths, and laboratory abnormalities., Major complications associated with CRS and HIPEC will be measured using NCI-CTCAE v5., Quality of life will be assessed before/after neoadjuvant metronomic chemotherapy, and 30 days after the surgery with EORTC-QLQ-30 and EQ-5D-5L., Progression-free Survival (PFS) is the time between the date of chemotherapy commencement and the date of Disease-Progression or Death, whichever occurs first., Overall Survival (OS) is the time between the date of chemotherapy commencement and date of Death or last follow up., Conduction of biological studies.

Source: https://euclinicaltrials.eu/ctis-public/view/2024-514329-42-00